EU clinical trial 2023-508255-39-00: The effect of noradrenaline infusion versus standard blood pressure management on perioperative HYPotension in NOncaRdiac surgery.
Protocol code: HYP-NOR
Sponsor: Uniwersytet Jagiellonski Collegium Medicum (Educational Institution). Phase: Therapeutic confirmatory (Phase III). Countries: Poland (ongoing, recruiting).
Therapeutic area(s): Analytical, Diagnostic and Therapeutic Techniques and Equipment [E] - Anesthesia and Analgesia [E03]; Diseases [C] - Cardiovascular Diseases [C14]
Gender: Female, Male. Age: 18-64 years, 65+ years. Enrolment: 750.
Status: Ongoing, recruiting. Start date (EU): 2025-06-16. Decision date: 2024-07-22. Results received: No. Last updated: 2026-04-28.

Condition(s): hypotension in non-cardiac surgery
Product: LEVONOR,1 mg/ml, roztwór do infuzji

Primary endpoint: The primary outcome is perioperative hypotension, defined as any mean arterial pressure (MAP) reading ≤55 mmHg during and up to 4 hours after noncardiac surgery.
Endpoint(s): Secondary outcomes include time under MAP ≤60 mm Hg intraoperatively and postoperatively; a composite of major perfusion-related complications: myocardial injury after noncardiac surgery (MINS), acute kidney injury (AKI), stroke, non-fatal cardiac arrest, sepsis, and death of all causes; infusion-related reactions; days alive and at home up to 30 days after surgery.

Source: https://euclinicaltrials.eu/ctis-public/view/2023-508255-39-00